EU clinical trial 2024-514876-41-00: GFM-ONUVEN-MDS : A phase I/II, open-label, single arm, multicenter dose-finding study to assess the safety and preliminary efficacy of Oral Azacitidine CC-486 (ONUREG®) in combination with Venetoclax (VENCLYXTO®) in previously untreated higher-risk myelodysplastic syndromes ineligible for allogenic transplantation
Protocol code: GFM-ONUVEN-MDS
Sponsor: Groupe Francophone Des Myelodysplasies (Patient organisation/association). Phase: Phase I and Phase II (Integrated)- Other. Countries: France (ongoing, recruitment ended).
Therapeutic area(s): Diseases [C] - Hemic and Lymphatic Diseases [C15]
Gender: Female, Male. Age: 18-64 years, 65+ years. Enrolment: 36.
Status: Ongoing, recruitment ended. Start date (EU): 2023-12-06. Decision date: 2024-10-29. Results received: No. Last updated: 2026-06-29.

Condition(s): Higher-risk myelodysplastic syndromes untreated and ineligible for allogenic transplantation
Product: Venetoclax, azacitidine, azacitidine

Primary endpoint: Dose-limiting toxicity (DLT) at day 28 of cycle 1, Overall response (OR) measured at day 28 of cycle 1 according to modified IWG-MDS 2006
Endpoint(s): Best response evaluated according to modified IWG-MDS 2006 criteria in the first 6 cycles (complete remission (CR), partial remission (PR), marrow complete response (mCR), stable disease (SD), failure, relapse after CR or PR, cytogenetic response, disease progression). Overall response (OR) defined as CR + PR + mCR, Best hematological improvement (HI) according to IWG-MDS 2006 criteria (erythroid HI (HI-E), neutrophil HI (HI-N), platelet HI (HI-P)), Best response evaluated according to IWG-HR-MDS 2023 criteria in the first 6 cycles (complete remission (CR), complete remission equivalent (CR equivalent), partial remission (PR), complete remission with limited count recovery (CRL), complete remission with partial hematological recovery (CRh), hematologic improvement (HI), overall response rate (ORR), no response, not evaluable, cytogenetic response, disease progression, disease relapse), Time to response, Duration of response, Progression to AML, Time to next treatment, Outcome and survival: Early mortality rate at day 28 ; overall survival (OS) ; event-free-survival (EFS) ; progression-free survival (PFS) ; time to relapse (DFS), RBC and platelet transfusion independence for transfusion-dependent patients at baseline, Duration of transfusion independence, Toxicity profile including cytopenia duration, life-threatening or fatal cytopenias, unscheduled hospitalization, infectious complications, RBC and platelets transfusions needs, Patient-reported outcomes and QoL auto-assessment: Fatigue - FACIT-An (Functionnal Assessment of Chronic Illness Therapy Anemia) ; Health Utility Index - 5 levels of EuroQoL-5D (EQ-5D-5L) ; Patient global impression of change (PGIC) ; Patient global impression of severity (PGIS). Change in QoL from baseline, as measured by questionnaires above.

Source: https://euclinicaltrials.eu/ctis-public/view/2024-514876-41-00